EU clinical trial 2024-513056-15-00: Phase I Study of PM534 Administered to Patients with Advanced Solid Tumors
Protocol code: PM534-A-001-22
Sponsor: Pharma Mar S.A. (Pharmaceutical company). Phase: Phase I and Phase II (Integrated)- First administration to humans. Countries: Spain (ongoing, recruiting).
Therapeutic area(s): Diseases [C] - Neoplasms [C04]
Gender: Female, Male. Age: 18-64 years, 65+ years. Enrolment: 145.
Status: Ongoing, recruiting. Start date (EU): 2022-12-01. Decision date: 2024-04-30. Results received: No. Last updated: 2026-04-06.

Condition(s): Advanced Solid Tumors

Source: https://euclinicaltrials.eu/ctis-public/view/2024-513056-15-00